EU clinical trial 2025-522655-26-00: METAREM / META-1 - METAREM : Adaptive Master Trial for Advanced Cancers with Rapid Evaluation of Molecular & Immune Status for Stratified Immunotherapies in Oncology / META-1 : Anti-PD1 monotherapy in 1L advanced NSCLC patients with PDL1 TPS > 50% and PTI=0
Protocol code: UC-IMM-2511/2512
Sponsor: Unicancer (Hospital/Clinic/Other health care facility). Phase: Therapeutic exploratory (Phase II). Countries: France (authorised, recruitment pending).
Therapeutic area(s): Diseases [C] - Neoplasms [C04]
Gender: Female, Male. Age: 18-64 years, 65+ years. Enrolment: 55.
Status: Authorised, recruitment pending. Decision date: 2026-04-16. Results received: No. Last updated: 2026-04-16.

Condition(s): METAREM:Patients with advanced cancer, as defined as unresectable locally advanced malignancies or metastatic cancers (including leukemias and lymphomas). META-1: Patients in first-line therapy for advanced metastatic NSCLC with PD-L1 Tumor Proportion Score (TPS) >50%, without EGFR/ ALK/ ROS1 mutations and irrespective of their histological subtype (squamous or non-squamous)
Product: KEYTRUDA 25 mg/mL concentrate for solution for infusion., LIBTAYO 350 mg concentrate for solution for infusion.

Primary endpoint: META-1: The primary endpoint is the rate of patients without disease progression at 12 weeks.
Endpoint(s): META-1: An assessment of treatment activity in patients with a baseline plasma PTI score = 0 in terms of: Objective Response Rate (ORR), Durable Clinical Benefit (DCB) is defined as the percentage of patient alive andwithout disease progression (CR + PR + stable disease [SD] as assessed by the investigator according to RECIST v1.1). Overall Survival (OS). Progression Free Survival (PFS), META-1: For patients with a baseline plasma PTI score = 0, safety will be evaluated according to the incidence of adverse events (AEs) graded by the National Cancer Institute - common terminology criteria for adverse events NCI-CTCAE v 6.0. The PRO-CTCAE questionnaire will be also used to assess the safety profile at weekly intervals., META-1: Health-related quality of life will be evaluated through the EORTC QLQ-C30 questionnaire by collecting data at inclusion and once every 3 months until the end of the treatment in patients with a baseline plasma PTI score = 0 and patients with a baseline plasma PTI score ≥1., META-1: For patients with a baseline plasma PTI score ≥1, Progression Free Survival (PFS) is defined as the time from inclusion until progressive disease assessed by the investigator according to standard of care or death from any cause, whichever occurs first. Patients without documented progression will be censored at last disease assessment or at initiation of new anticancer treatment (if applicable)., META-1: For patients with a baseline plasma PTI score ≥1, safety will be evaluated according to the incidence of adverse events (AEs) graded by the National Cancer Institute - common terminology criteria for adverse events NCI-CTCAE v 6.0 as per standard of care. The PRO-CTCAE questionnaire will also be used to assess the safety profile at weekly intervals.

Source: https://euclinicaltrials.eu/ctis-public/view/2025-522655-26-00